EU clinical trial 2024-515751-38-00: Safety, Tolerability and Pharmacokinetic Profile of TPT0301 in Healthy Volunteers
Protocol code: TPT0301-001
Sponsor: Tetra Pharm Technologies ApS (Pharmaceutical company). Phase: Human Pharmacology (Phase I)- First administration to humans. Countries: Germany (authorised, recruitment pending).
Therapeutic area(s): Diseases [C] - Nervous System Diseases [C10]
Gender: Female, Male. Age: 18-64 years. Enrolment: 18.
Status: Authorised, recruitment pending. Decision date: 2024-10-29. Results received: No. Last updated: 2025-02-20.

Condition(s): adjunctive neuropathic pain

Source: https://euclinicaltrials.eu/ctis-public/view/2024-515751-38-00